EU clinical trial 2025-521059-21-00: A Phase 2b, Randomized, Double-Blind, Placebo-Controlled Study to Evaluate the Efficacy and Safety of Tulisokibart in Participants With Radiographic Axial Spondyloarthritis (Ankylosing Spondylitis)
Protocol code: MK-7240-013
Sponsor: Merck Sharp & Dohme LLC (Pharmaceutical company). Phase: Therapeutic exploratory (Phase II). Countries: Netherlands (ongoing, recruiting), Germany (ongoing, recruiting), Poland (ongoing, recruiting).
Therapeutic area(s): Diseases [C] - Musculoskeletal Diseases [C05]
Gender: Female, Male. Age: 18-64 years, 65+ years. Enrolment: 62.
Status: Ongoing, recruiting. Start date (EU): 2025-11-25. Decision date: 2025-10-30. Results received: No. Last updated: 2026-08-04.
Decision dates by country: DE: 2025-10-31, PL: 2025-10-31, NL: 2025-10-30

Condition(s): Radiographic axial spondyloarthritis (as known as ankylosing spondylitis)
Product: Placebo for MK-7240, tulisokibart

Primary endpoint: Percentage of participants achieving Assessment of SpondyloArthritis international Society (ASAS) 40 response at Week 16.
Endpoint(s): Percentage of participants achieving Ankylosing Spondylitis Disease Activity Score (ASDAS) <2.1 at Week 16., Change from baseline in Bath Ankylosing Spondylitis Functional Index (BASFI) at Week 16., Change from baseline in the Spondyloarthritis Research Consortium of Canada (SPARCC) magnetic resonance imaging (MRI) score for spine at Week 16., Change from baseline in the SPARCC MRI score for sacroiliac joint (SIJ) at Week 16., Change from baseline in total spinal pain Bath Ankylosing Spondylitis Disease Activity Index (BASDAI) Question 2 (Q2) at Week 16., Change from baseline in nocturnal spinal pain at Week 16., Change from baseline in Assessment of SpondyloArthritis international Society Health Index (ASAS HI) at Week 16., Change from baseline in short form-36 health survey (SF-36) physical component summary (PCS) at Week 16., Change from baseline in BASDAI at Week 16., Change from baseline in Maastricht Ankylosing Spondylitis Enthesitis Score (MASES) at Week 16 in the subgroup of participants with enthesitis (MASES>0) at baseline., Change from baseline in Bath Ankylosing Spondylitis Metrology Index Linear (BASMIlin) at Week 16., Change from baseline in Functional Assessment of Chronic Illness Therapy – Fatigue Scale (FACIT-Fatigue) at Week 16., Number of Participants With One or More adverse events (AEs)., Number of Participants Who Discontinued Study Intervention Due to an AE.

Source: https://euclinicaltrials.eu/ctis-public/view/2025-521059-21-00